EU clinical trial 2024-514750-67-00: “A Phase II, double-blinded, placebo-controlled clinical trial to evaluate the safety and efficacy of mesenchymal cells (MSV-ALLO®) in the treatment of lupus nephritis”
Sponsor: Hospital Universitario Rio Hortega (Hospital/Clinic/Other health care facility). Phase: Phase II and Phase III (Integrated). Countries: Spain (ongoing, recruiting).
Therapeutic area(s): Diseases [C] - Immune System Diseases [C20]
Gender: Female, Male. Age: 18-64 years. Enrolment: 20.
Status: Ongoing, recruiting. Start date (EU): 2022-09-13. Decision date: 2024-11-20. Results received: No. Last updated: 2024-11-20.

Condition(s): Lupus Nephritis
Product: MSV-allo

Primary endpoint: The primary endpoint is the proportion of patients who have achieved complete response or partial response at week 24, relative to their baseline (treatment visit), in the treatment group compared to the placebo group.
Endpoint(s): Proportion of patients at week 24 whose dose of prednisone-equivalent corticosteroids has been reduced relative to the screening visit by # 25% and to a dose # 7.5 mg/day and who have no exacerbation BILAG A or 2B . A BILAG A or 2B exacerbation is defined as at least one new BILAG A organic domain score or at least 2 new BILAG B organic domain scores compared to the screening visit., Proportion of patients at each visit whose prednisone-equivalent dose has been reduced relative to the screening visit by # 25% and at a dose # 7.5 mg/day, and who do not have any BILAG A or 2B exacerbations at the disease activity, Proportion of patients at week 24 with a reduction relative to the screening visit in the daily dose of prednisone-equivalent corticosteroids of 0-<25%, 25%-50%, >50%., Cumulative dose of prednisone-equivalent corticosteroids from the screening visit to week 24, Proportion of patients who before week 24 have reduced the dose of immunosuppressants and who do not present any BILAG A or 2B exacerbation, Change from day 1 (treatment) in SF-36 and LupusQoL scores, Change from day 1 (treatment) in proteinuria levels, Change from day 1 (treatment) in the SLEDAI-2K index.

Source: https://euclinicaltrials.eu/ctis-public/view/2024-514750-67-00